EU clinical trial 2025-523172-23-00: A phase 1, open-label, dose-escalation and dose-expansion study evaluating the safety, feasability and efficacy of ODI-2001 vaccine, a personalized immunotherapy, in patients with metastatic or locally advanced colon cancer of pancreatic cancer
Protocol code: ODI-2001-01
Sponsor: Centr Georges Francois Leclerc (Hospital/Clinic/Other health care facility). Phase: Human Pharmacology (Phase I)- First administration to humans. Countries: France (authorised, recruitment pending).
Therapeutic area(s): Diseases [C] - Digestive System Diseases [C06]
Gender: Female, Male. Age: 18-64 years, 65+ years. Enrolment: 83.
Status: Authorised, recruitment pending. Decision date: 2026-02-10. Results received: No. Last updated: 2026-02-10.

Condition(s): Metastatic or locally advanced pancreatic cancer, Metastatic or locally advanced colorectal cancer

Source: https://euclinicaltrials.eu/ctis-public/view/2025-523172-23-00